EU clinical trial 2023-509877-22-00: A Phase 3, Prospective, Open-label, Uncontrolled, Multicenter Study on Efficacy and Safety of Prophylaxis with Vonicog Alfa (rVWF) in Children Diagnosed With Severe von Willebrand disease.
Protocol code: TAK-577-3001
Sponsor: Takeda Development Center Americas Inc. (Pharmaceutical company). Phase: Therapeutic confirmatory (Phase III). Countries: Italy (ended), France (ongoing, recruiting), Ireland (ongoing, recruiting), Spain (ended).
Therapeutic area(s): Diseases [C] - Hemic and Lymphatic Diseases [C15]
Gender: Female, Male. Age: 0-17 years. Enrolment: 11.
Start date (EU): 2024-10-30. Decision date: 2024-08-22. Results received: No. Last updated: 2026-07-03.
Decision dates by country: ES: 2024-08-23, FR: 2024-08-22, IE: 2024-08-23, IT: 2024-09-02

Condition(s): severe von Willebrand Disease
Product: VEYVONDI 1300 IU powder and solvent for solution for injection., ADVATE 500 IU/2 ml powder and solvent for solution for injection, VEYVONDI 650 IU powder and solvent for solution for injection, ADVATE 1 000 IU/2 ml powder and solvent for solution for injection

Primary endpoint: Annualized bleeding rate (ABR) with intra-patient control (on-study compared to historical) for all (both spontaneous and traumatic) bleeding episodes classified by the investigator as either spontaneous or traumatic during prophylactic treatment with vonicog alfa (rVWF)
Endpoint(s): Safety: a)AEs/serious AEs (SAEs): incidence, severity, causality, b) Occurrence of thromboembolic events, c) Occurrence of hypersensitivity reactions, d) Occurrence of infusion-related reactions (IRRs), e) Immunogenicity, f) Development of neutralizing antibodies (inhibitors) to VWF and FVIII, g) Development of binding antibodies to VWF and FVIII, i) Clinically significant changes in vital signs and clinical laboratory parameters relative to baseline, Efficacy of Prophylaxis: a) Categorized ABR defined as 0, >0 to 2, >2 to 5, or >5 during vonicog alfa (rVWF) prophylaxis, b) ABR percent reduction success for Prior OD subjects, defined as at least 25% reduction of ABR for spontaneous bleeding episodes during vonicog alfa (rVWF) prophylaxis relative to the subject's own historical ABR during OD treatment prior to enrollment in this study, c) ABR preservation success for plasma-derived (pd)VWF Switch subjects, defined as achieving an ABR for spontaneous bleeding episodes during vonicog alfa (rVWF) prophylaxis that is no greater than the subject's own historical ABR during prophylactic treatment with pdVWF prior to enrollment in this study, d) ABR for spontaneous bleeding episodes by location of bleeding (gastrointestinal [GI], epistaxis, joint bleeding, menorrhagia/HMB, oral and other mucosa, muscle and soft tissue) historically and while on prophylactic treatment with vonicog alfar (VWF), e) ABR for bleeding episodes by cause (spontaneous, traumatic [injury related], menstrual bleeding, surgical, unknown) historically and while on prophylactic treatment with vonicog alfa (rVWF), g) Total number of infusions and average number of infusions per week during prophylactic treatment with vonicog alfa (rVWF), h) Total weight-adjusted consumption of vonicog alfa (rVWF) per month during prophylactic treatment, Efficacy of on demand (OD) Treatment of Breakthrough Bleeding Episodes: a) Overall hemostatic efficacy rating of breakthrough bleed treatment at resolution of the bleeding episode, b) Number of infusions of vonicog alfa (rVWF) and ADVATE utilized to treat breakthrough bleeding episodes, c) Weight-adjusted consumption of vonicog alfa (rVWF) and ADVATE per breakthrough bleeding episode, Pharmacokinetic/Pharmacodynamic Endpoints (PK/PD): a) Sparse PK/PD concentrations at scheduled time points for VWF:RCo, VWF:Ag, VWF:CB, VWFGP1bM, and FVIII:C, b) Incremental recovery (IR) for VWF:RCo, VWF:Ag, VWF:CB, and VWF:GP1bM, c) PK parameters at steady state:t1/2,area under the concentration versus time curve over a dosing interval/area under the concentration versus time curve from 0 to 96 hours,Cmax, ss, time to reach the maximum plasma concentration, volume of distribution at steady state, CLss based on VWF:RCo. The corresponding PD of vonicog alfa (rVWF) as measured in FVIII:C will be assessed using Cmax, ss, Tmax, ss, and AUCtau, ss/AUC0-96hr, ss.

Source: https://euclinicaltrials.eu/ctis-public/view/2023-509877-22-00